EU clinical trial 2025-523660-21-00: C0371017 - A PHASE 3, NON-INVESTIGATIONAL PRODUCT, MULTI COUNTRY COHORT STUDY TO DESCRIBE THE LONG-TERM SAFETY AND EFFECTIVENESS OF A PRIOR SINGLE-DOSE TREATMENT WITH INVESTIGATIVE GIROCTOCOGENE FITELPARVOVEC OR FIDANACOGENE ELAPARVOVEC IN PARTICIPANTS WITH HEMOPHILIA A OR HEMOPHILIA B, RESPECTIVELY
Protocol code: C0371017
Sponsor: Pfizer Inc. (Pharmaceutical company). Phase: Therapeutic confirmatory (Phase III). Countries: Italy (authorised, recruitment pending), Germany (authorised, recruitment pending), France (authorised, recruitment pending), Spain (authorised, recruitment pending), Sweden (authorised, recruitment pending), Greece (ongoing, recruiting).
Therapeutic area(s): Diseases [C] - Hemic and Lymphatic Diseases [C15]
Gender: Male. Age: 18-64 years. Enrolment: 31.
Start date (EU): 2026-07-22. Decision date: 2026-04-20. Results received: No. Last updated: 2026-07-20.
Decision dates by country: IT: 2026-04-24, GR: 2026-05-08, DE: 2026-04-24, SE: 2026-05-08, FR: 2026-05-08, ES: 2026-05-08

Condition(s): hemophilia A, severe to moderately severe hemophilia B (FIX:C ≤ 2%)
Product: giroctocogene fitelparvovec, fidanacogene elaparvovec

Primary endpoint: Incidence of thromboembolic events, Incidence of factor inhibitor development, Incidence of hepatic malignancy, Incidence of liver abnormalities, Factor activity level
Endpoint(s): Total ABR (treated and untreated), Incidence of and time from previously administered gene therapy infusion to resumption of prophylaxis, AIR of exogenous factor, Consumption of exogenous factor, Incidence of Non-hepatic malignancy, Incidence of Auto-immune disorders, Incidence of SAEs, All cause-mortality, EQ-5D-5L dimension and VAS scores

Source: https://euclinicaltrials.eu/ctis-public/view/2025-523660-21-00